EU clinical trial 2024-512089-32-00: A Phase 1b Open-Label Study to Evaluate the Safety and Anti-cancer Activity of Loncastuximab Tesirine in Combination with Other Anti-cancer Agents in Patients with Relapsed or Refractory B-cell Non-Hodgkin Lymphoma (LOTIS-7)
Protocol code: ADCT-402-105
Sponsor: ADC Therapeutics SA (Pharmaceutical company). Phase: Human Pharmacology (Phase I)- Other. Countries: Italy (ongoing, recruiting), Spain (ongoing, recruiting), Czechia (ongoing, recruiting), Belgium (ongoing, recruiting).
Therapeutic area(s): Diseases [C] - Neoplasms [C04]
Gender: Female, Male. Age: 18-64 years, 65+ years. Enrolment: 121.
Status: Ongoing, recruiting. Start date (EU): 2022-03-28. Decision date: 2024-04-09. Results received: No. Last updated: 2026-03-02.
Decision dates by country: CZ: 2024-04-09, ES: 2024-04-09, IT: 2024-04-12, BE: 2024-04-24

Condition(s): Relapsed or Refractory B-cell Non-Hodgkin Lymphoma

Source: https://euclinicaltrials.eu/ctis-public/view/2024-512089-32-00